EU clinical trial 2024-518201-18-00: Study of Personalized Neoantigen Specific TCR T cells in the Treatment of Advanced Solid Cancers
Protocol code: NT-125-101
Sponsor: Neogene Therapeutics B.V. (Pharmaceutical company). Phase: Human Pharmacology (Phase I)- First administration to humans. Countries: Netherlands (ended).
Therapeutic area(s): Diseases [C] - Neoplasms [C04]
Gender: Female, Male. Age: 18-64 years, 65+ years. Enrolment: 42.
Status: Ended. Start date (EU): 2022-04-28. End date (EU): 2025-06-11. Decision date: 2024-12-02. Results received: No. Last updated: 2024-12-02.

Condition(s): Advanced Solid Cancers

Source: https://euclinicaltrials.eu/ctis-public/view/2024-518201-18-00